EU clinical trial 2023-508262-15-00: A Phase I/II, Open-label, Dose Escalation and Dose Expansion Study to Evaluate the Safety, Pharmacokinetics, Pharmacodynamics, and Efficacy of AZD2936 Anti TIGIT/Anti-PD-1 Bispecific Antibody in Participants with Advanced or Metastatic Non small Cell Lung Cancer (ARTEMIDE-01).
Protocol code: D7020C00001
Sponsor: AstraZeneca AB (Pharmaceutical company). Phase: Phase I and Phase II (Integrated)- First administration to humans. Countries: Belgium (ongoing, recruitment ended), Netherlands (ongoing, recruitment ended), Denmark (ongoing, recruitment ended), France (ongoing, recruitment ended), Spain (ongoing, recruitment ended).
Therapeutic area(s): Diseases [C] - Neoplasms [C04]
Gender: Female, Male. Age: 18-64 years, 65+ years. Enrolment: 61.
Status: Ongoing, recruitment ended. Start date (EU): 2021-09-09. Decision date: 2024-04-03. Results received: No. Last updated: 2026-06-22.
Decision dates by country: ES: 2024-04-05, DK: 2024-04-03, BE: 2024-04-15, FR: 2024-04-05, NL: 2024-04-04

Condition(s): Advanced Non-small Cell Lung Cancer, Metastatic Non-small Cell Lung Cancer, stage III unresectable Non-small Cell Lung Cancer (Protocol Parts A-B), stage IV Non-small Cell Lung Cancer (Protocol Parts A-E).
Product: Rilvegostomig, Rilvegostomig

Primary endpoint: The ORR is defined as The percentage of participants with a confirmed CR or PR, with The denominator defined as The number of participants in The response evaluable set. Objective response rate and its CIs will be summarized by dose regimen. Percentage of participants with AEs and imAEs, SAEs, DLTs, vital signs, and abnormal laboratory parameters Rate of rilvegostomig discontinuation due to toxicity
Endpoint(s): Best Overall Response is defined as the best response a subject has had following start of dosing, but prior to starting any subsequent cancer therapy and up to and including RECIST progression or the last evaluable assessment in the absence of RECIST progression. Categorization of BOR is based on RECIST using the following response categories: CR, PR, SD, PD, and not evaluable (NE)., The DoR is defined as the time from the date of first documented response until the date of documented progression or death in the absence of disease progression. Only participants who have achieved confirmed CR or PR will be included in the summaries of DoR. The DoR will be summarized using descriptive statistics and Kaplan Meier plots, where there are sufficient numbers of responders., Disease control rate at time point of interest is defined as the percentage of participants who have a best objective response of confirmed CR or PR or who have SD lasting for at least a certain time of period after start of treatment. The DCR and its exact CIs will be summarized by dose regimen., The DRR is defined as the percentage of participants who have a confirmed CR or PR with duration of response lasting ≥ 6 months. The DRR and its exact CIs will be summarized by dose regimen., Time to response (TTR) is defined as the time from the first dose until the first documentation of a subsequently confirmed objective response. Only participants who have achieved confirmed CR or PR will be included in the summaries of TTR. The TTR will be summarized using the Kaplan-Meier method, where there are sufficient numbers of responders., The best percentage change from baseline in tumor size is the largest decrease (or smallest increase) for a participant, using RECIST assessments., Progression-free survival is defined as the time from the start of treatment until the date of objective disease progression or death (by any cause in the absence of progression), regardless of whether the participant withdraws from study therapy or receives another anti-cancer therapy prior to progression., Measure the RO of TIGIT and PD 1 on peripheral blood T cells for parts A and B, Incidence of ADAs against rilvegostomig in serum, Serum concentrations and PK parameters (where applicable) of rilvegostomig; PK parameters to be evaluated include but not limited to Cmax, AUC, clearance, and t1/2

Source: https://euclinicaltrials.eu/ctis-public/view/2023-508262-15-00